EU clinical trial 2022-503108-26-00: A Phase 1b/2 Study of BMS-986442 in Combination with Nivolumab or Nivolumab and Chemotherapies in Participants with Advanced Solid Tumors and Non-small Cell Lung Cancer
Protocol code: CA115-001
Sponsor: Bristol-Myers Squibb Services Unlimited Company (Pharmaceutical company). Phase: Phase I and Phase II (Integrated)- First administration to humans. Countries: Spain (ended), Italy (ended), Poland (ended).
Therapeutic area(s): Diseases [C] - Neoplasms [C04]
Gender: Female, Male. Age: 18-64 years, 65+ years. Enrolment: 106.
Status: Ended. Start date (EU): 2023-11-06. End date (EU): 2024-09-04. End date: 2024-09-12. Decision date: 2023-07-19. Results received: Yes. Last updated: 2024-07-23.
Decision dates by country: ES: 2023-07-24, PL: 2023-07-24, IT: 2023-07-19

Condition(s): Solid Tumor, Non-small cell lung cancer
Product: DOCETAXEL, OPDIVO 10 mg/mL concentrate for solution for infusion., PACLITAXEL, AGEN1777, CARBOPLATIN, PEMETREXED DISODIUM

Primary endpoint: Incidence of AEs, SAEs, AEs meeting protocol defined DLT criteria, AEs leading to discontinuation, and death (per CTCAE v5.0).
Endpoint(s): Summary measures of BMS-986442 PK parameters (such as, but not limited to, Cmax, Tmax, and AUC), Incidence of ADAs, and anti tumor efficacy parameters (ORR, DOR, DCR, and PFSR at 6 months and 12 months per RECIST v1.1 by Investigator)

Source: https://euclinicaltrials.eu/ctis-public/view/2022-503108-26-00